EU clinical trial 2022-500849-24-00: A Phase 1, First-in-Human, Open-label Study Evaluating the Safety, Tolerability, Pharmacokinetics, and Efficacy of TT125-802 in Subjects with Advanced Solid Tumors
Protocol code: TT-CSP-001
Sponsor: Tolremo Therapeutics AG (Pharmaceutical company). Phase: Human Pharmacology (Phase I)- First administration to humans. Countries: Spain (ended).
Therapeutic area(s): Diseases [C] - Neoplasms [C04]
Gender: Female, Male. Age: 18-64 years, 65+ years. Enrolment: 40.
Status: Ended. Start date (EU): 2023-11-07. End date (EU): 2026-06-26. End date: 2026-06-30. Decision date: 2023-09-27. Results received: No. Last updated: 2026-06-12.

Condition(s): Advanced Solid Tumors

Source: https://euclinicaltrials.eu/ctis-public/view/2022-500849-24-00